EU clinical trial 2024-519554-37-00: A Phase 3, Double-Blind, Randomized, Two-Period, Multicenter, Placebo-Controlled, Efficacy and Safety Study of JNT-517 for the Treatment of Participants with Phenylketonuria
Protocol code: JNT517-301
Sponsor: Otsuka Pharmaceutical Development & Commercialization Inc. (Pharmaceutical company). Phase: Therapeutic confirmatory (Phase III). Countries: Czechia (ongoing, recruiting), Italy (ongoing, recruiting), Spain (ongoing, recruiting), Netherlands (ongoing, recruiting), Poland (ongoing, recruiting), France (authorised, recruitment pending), Germany (ongoing, recruiting).
Therapeutic area(s): Diseases [C] - Nervous System Diseases [C10]; Diseases [C] - Congenital, Hereditary, and Neonatal Diseases and Abnormalities [C16]; Diseases [C] - Nutritional and Metabolic Diseases [C18]
Gender: Female, Male. Age: 18-64 years, 65+ years. Enrolment: 38.
Start date (EU): 2026-01-16. Decision date: 2025-11-03. Results received: No. Last updated: 2026-03-17.
Decision dates by country: CZ: 2025-11-04, FR: 2025-11-04, DE: 2025-11-03, IT: 2025-11-14, ES: 2025-11-07, PL: 2025-11-13, NL: 2025-11-12

Condition(s): Phenylketonuria
Product: JNT-517 Placebo, JNT-517, JNT-517

Primary endpoint: Absolute change in plasma phenylalanine (Phe) levels from baseline to mean of Weeks 2, 4, and 6 in the JNT-517 150 mg BID dose group at end of Period 1
Endpoint(s): Percent change in plasma Phe levels from baseline to mean of Weeks 2, 4, and 6 in the JNT-517 150 mg BID group at end of Period 1. Participants achieving plasma Phe <600 µmol/L at end of Period 1 among those with baseline ≥600 µmol/L in the 150 mg BID and 75 mg BID groups, respectively. Participants achieving plasma Phe levels <360 µmol/L at end of Period 1 in the 150 mg BID and 75 mg BID groups, respectively... (contd), Change from baseline in the ADHD-RS-5 inattentive subscore in participants with baseline inattentive subscore >9 in the JNT-517 150 mg BID and 75 mg BID dose groups, respectively at end of Period 1., Change from baseline in dietary Phe intake as determined by 3-day diet diary reports and while achieving plasma Phe <360 µmol/L in those participating in the diet normalization., Incidence of treatment-emergent adverse events (TEAEs) and serious TEAEs in Periods 1 and 2., Participants with reduction from baseline ≥30% and ≥50% in plasma Phe levels at Week 6 in Period 1. Participants achieving plasma Phe levels <120 µmol/L at end of Period 1 in the 150 mg BID and 75 mg BID groups, respectively. Absolute and percent change in plasma Phe from baseline to Weeks 2, 4, and 6 of Period 1 in the 150 mg BID and 75 mg BID groups, respectively., Participants achieving plasma Phe <600 µmol/L among the participants with a baseline Phe ≥600 µmol/L in each of the JNT 517 75 mg BID and 150 mg BID dose groups at end of Period 2. Participants who achieve plasma Phe levels <360 µmol/L in each of the JNT-517 75 mg BID and 150 mg BID dose groups at end of Period 2. Participants who achieve plasma Phe levels <120 µmol/L in each of the JNT-517 75 mg BID and 150 mg BID dose groups at end of Period 2... (contd), Change from baseline in the Cambridge Neuropsychological Test Automated Battery (CANTAB) stop signal reaction time in each of the JNT-517 75 mg BID and 150 mg BID dose groups, respectively, at the end of Period 1. Change from baseline in CANTAB stop signal reaction time in both JNT-517 dose groups during Period 2. Change from baseline in ADHD-RS-5 inattentive subscore in participants with baseline inattentive subscore >9 in both JNT 517 dose groups during Period 2., Change from baseline in dietary protein intake while maintaining plasma Phe <360 µmol/L in those participating in the diet normalization. Participants achieving the recommended dietary allowance (RDA) for natural intact protein intakes while maintaining plasma Phe <360 µmol/L in those participating in the diet normalization. Participants achieving 2 × RDA for natural intact protein intakes, consistent with an unrestricted diet, while maintaining plasma Phe <360 µmol/L... (contd)

Source: https://euclinicaltrials.eu/ctis-public/view/2024-519554-37-00